EU clinical trial 2022-500218-25-01: Interest of systematic treatment with PPI after endoscopic myotomy compared to PPI treatment in case of symptoms in prevention of gastroesophageal reflux after POEM for esophageal achalasia. Randomized open-label clinical trial
Protocol code: GCSMERRI/2020/LC-01
Sponsor: CHU de Nimes (Pharmaceutical company). Phase: Therapeutic use (Phase IV). Countries: France (ongoing, recruiting).
Therapeutic area(s): Diseases [C] - Digestive System Diseases [C06]
Gender: Female, Male. Age: 18-64 years, 65+ years. Enrolment: 132.
Status: Ongoing, recruiting. Start date (EU): 2023-06-01. Decision date: 2023-02-27. Results received: No. Last updated: 2026-02-03.

Condition(s): esophageal achalasia
Product: Lansoprazole 30mg Orodispersible Tablets

Primary endpoint: Presence of pathological acid reflux according to the Lyon 2018 criteria (26) at 6 months: This is a composite endpoint presence of: - Esophagitis grade C or D according to the Los Angeles classification. And / or - Acid exposure >6% on 24-hour esophageal pH-metry.
Endpoint(s): Presence of pathologic acid reflux according to the 2018 Lyon criteria (26) at 12 months: A) Esophagitis grade C or D B) Acid exposure >6% at 24-hour pH impedancemetry, Score aux questionnaires de qualité de vie : A) WHOQOL-BREF B) GERD HRQL, Quantity of Lansoprazole consumed (Number of boxes consumed): generic form, Occurrence of an adverse reaction, Post POEM dysphagia assessment: Eckardt score >3, Assessment of pH-impedancemetry profile at 6 and 12 months defined by Rome IV criteria (Acid Reflux, Esophageal Hypersensitivity, Functional Pyrosis, Normal).

Source: https://euclinicaltrials.eu/ctis-public/view/2022-500218-25-01